EU clinical trial 2025-522731-34-00: A trial to learn how safe AZD5335 is and if a drug called itraconazole changes how AZD5335 moves through the body over time in adults with ovarian, peritoneal, or fallopian tube cancer
Protocol code: D8991C00002
Sponsor: AstraZeneca AB (Pharmaceutical company). Phase: Human Pharmacology (Phase I)- Other. Countries: Spain (ongoing, recruiting), Ireland (ongoing, recruiting), Portugal (ongoing, recruiting).
Therapeutic area(s): Diseases [C] - Neoplasms [C04]
Gender: Female. Age: 18-64 years, 65+ years. Enrolment: 34.
Status: Ongoing, recruiting. Start date (EU): 2026-01-23. Decision date: 2026-01-15. Results received: No. Last updated: 2026-04-27.
Decision dates by country: IE: 2026-01-16, ES: 2026-01-15, PT: 2026-02-10

Condition(s): Ovarian cancer; Primary peritoneal cancer; Fallopian tube cancer

Source: https://euclinicaltrials.eu/ctis-public/view/2025-522731-34-00